EU clinical trial 2024-516881-12-00: S1404: A Phase III Randomized Trial Comparing Physician/Patient Choice of Either High Dose Interferon or Ipilimumab to MK-3475 (Pembrolizumab) in Patients with High Risk Resected Melanoma.
Protocol code: CTRIAL-IE 16-12
Sponsor: Cancer Trials Ireland (Patient organisation/association). Phase: Therapeutic confirmatory (Phase III). Countries: Ireland (ongoing, recruitment ended).
Therapeutic area(s): Diseases [C] - Neoplasms [C04]
Gender: Female, Male. Age: 18-64 years, 65+ years. Enrolment: 3.
Status: Ongoing, recruitment ended. Start date (EU): 2017-07-05. Decision date: 2024-10-15. Results received: No. Last updated: 2026-04-01.

Condition(s): High risk resected melanoma.
Product: KEYTRUDA 25 mg/mL concentrate for solution for infusion

Primary endpoint: Progression/Relapse, Relapse-Free Survival, Overall Survival, Performance Status

Source: https://euclinicaltrials.eu/ctis-public/view/2024-516881-12-00